EU clinical trial 2022-500377-13-01: Randomized clinical trial to evaluate the utility of CYP2D6 genotyping to improve the efficacy and safety of tramadol in the treatment of acute postoperative pain
Protocol code: 1
Sponsor: Fundacion Para La Investigacion Biomedica Del Hospital Universitario La Princesa (Laboratory/Research/Testing facility). Phase: Therapeutic use (Phase IV). Countries: Spain (ongoing, recruitment ended).
Therapeutic area(s): Diseases [C] - Pathological Conditions, Signs and Symptoms [C23]; Analytical, Diagnostic and Therapeutic Techniques and Equipment [E] - Investigative Techniques [E05]
Gender: Female, Male. Age: 18-64 years, 65+ years. Enrolment: 300.
Status: Ongoing, recruitment ended. Start date (EU): 2022-10-05. Decision date: 2022-05-27. Results received: No. Last updated: 2025-03-31.

Condition(s): Pharmakogenetics, Therapeutic techniques in treatment of acute postoperative pain
Product: Metamizol Normon 575 mg cápsulas duras EFG., Paracetamol Normon 500 mg comprimidos EFG, Dexketoprofeno Normon 25 mg comprimidos recubiertos con película EFG, Tramadol Normon 50 mg cápsulas duras EFG, Tramadol Normon 100 mg cápsulas duras

Primary endpoint: This is a simple study, which does not differ from standard clinical practice and therefore we do not expect early ending of the study.

Source: https://euclinicaltrials.eu/ctis-public/view/2022-500377-13-01